EU clinical trial 2024-516813-19-00: Oxytocin substitution therapy in patients with AVP deficiency (central diabetes insipidus): a double-blind randomised placebo-controlled trial - the OxyTUTION trial
Protocol code: OxyTUTION
Sponsor: Universitaetsspital Basel (Hospital/Clinic/Other health care facility). Phase: Therapeutic exploratory (Phase II). Countries: Netherlands (ongoing, recruiting), Germany (ongoing, recruiting).
Therapeutic area(s): Phenomena and Processes [G] - Metabolism [G03]; Diseases [C] - Hormonal diseases [C19]
Gender: Female, Male. Age: 18-64 years, 65+ years. Enrolment: 70.
Status: Ongoing, recruiting. Start date (EU): 2025-02-26. Decision date: 2025-01-08. Results received: No. Last updated: 2026-01-08.
Decision dates by country: NL: 2025-01-08, DE: 2025-10-02

Condition(s): central diabetes insipidus
Product: OXYTOCIN, The placebo nasal spray will be identical in volume, labelling but not container system, and other features. The placebo will contain 0.9% sodium chloride and no OXT.

Primary endpoint: Trait anxiety level and correct classifications of facial & body expression after 28 (+/-2) days of treatment assessed with the STAI-T and the EmBody/EmFace Task. ▪ The STAI-T comprises 20 items scoring 1-4 points each. ▪ The EmBody/EmFace comprises 84 items scoring correct or incorrect each.
Endpoint(s): Emotion recognition and empathy, Hormonal and subjective response to psychological stress, Amygdala and subjective response in the functional MRI scan, Further psychological outcomes, Metabolic outcomes, Objective assessment of a close third person, Safety outcome

Source: https://euclinicaltrials.eu/ctis-public/view/2024-516813-19-00